EU clinical trial 2024-515420-37-01: Personalized Vitamin D Supplementation for Reducing or Preventing Fatigue and Enhancing Quality of Life of Patients with Colorectal Tumor: Randomized Intervention Trial (VICTORIA)
Protocol code: DKFZ-2019-001
Sponsor: Deutsches Krebsforschungszentrum Stiftung Des Oeffentlichen Rechts (Laboratory/Research/Testing facility). Phase: Therapeutic confirmatory (Phase III). Countries: Germany (ended).
Therapeutic area(s): Diseases [C] - Digestive System Diseases [C06]
Gender: Female, Male. Age: 18-64 years, 65+ years. Enrolment: 456.
Status: Ended. Start date (EU): 2020-09-28. End date (EU): 2025-07-15. Decision date: 2025-01-17. Results received: Yes. Last updated: 2025-01-17.

Condition(s): Fatigue in patients with colorectal cancer (CRC) (ICD codes C18-C20 and C21.8) within 12 months after a colorectal cancer therapy (surgery, chemotherapy and/or radiation) and not optimal vitamin D status (25-hydroxyvitamin D (25(OH)D) levels < 60 nmol/L)
Product: placebo capsule, COLECALCIFEROL

Primary endpoint: • Mean difference in FACIT-F fatigue subscale between intervention and placebo group at trial week 13-16

Source: https://euclinicaltrials.eu/ctis-public/view/2024-515420-37-01